EU clinical trial 2023-509624-17-00: Chiropractic spinal manipulative therapy for acute neck pain: a 4-armed clinical placebo randomized controlled trial
Sponsor: Akershus University Hospital (Hospital/Clinic/Other health care facility). Phase: Therapeutic use (Phase IV). Countries: Norway (ongoing, recruiting).
Therapeutic area(s): Diseases [C] - Musculoskeletal Diseases [C05]
Gender: Female, Male. Age: 18-64 years. Enrolment: 240.
Status: Ongoing, recruiting. Start date (EU): 2024-03-08. Decision date: 2024-03-08. Results received: No. Last updated: 2026-05-13.

Condition(s): Acute neck pain
Product: LACTOSE, Ibuprofen Orifarm 600 mg filmdragerade tabletter

Primary endpoint: Group 1) CSMT 2) CSMT sham manipulation 3) Ibuprofen medication 4) Placebo medication. The primary end-point will be defined as the mean pain intensity on a NRS 0-10. The primary analysis will assess the difference in mean pain intensity change from baseline to day 14 after baseline between group 1 and group 2, group 1 and group 3, and group 1 and group 4.
Endpoint(s): Group 1) CSMT 2) CSMT sham manipulation 3) Ibuprofen medication 4) Placebo medication. 1. Mean pain intensity (NRS 0-10) change from baseline to day 2, 3, 4, 5, 6, 7, 8, 9, 10, 11, 12, 13 in the treatment period, and from baseline to day 7, 28, 56, 84 and 168 post-treatment, respectively, and comparison between group 1 and group 2, group 1 and group 3, group 1 and group 4, and group 3 and 4. 2. Mean duration (hours) of neck pain change from baseline to day etc. See protocol for further details

Source: https://euclinicaltrials.eu/ctis-public/view/2023-509624-17-00